EU clinical trial 2025-520964-16-00: “Study of pain syndrome and clinical-biochemical parameters in children aged 7 to 18 years in cases of non-surgical treatment of uncomplicated acute appendicitis”
Sponsor: Riga Stradins University (Educational Institution). Phase: Phase III and phase IV (Integrated). Countries: Latvia (authorised, recruitment pending).
Therapeutic area(s): Diseases [C] - Digestive System Diseases [C06]
Gender: Female, Male. Age: 0-17 years. Enrolment: 120.
Status: Authorised, recruitment pending. Decision date: 2025-01-30. Results received: No. Last updated: 2025-01-30.

Condition(s): uncomplicated acute appendicitis
Product: KETOROLAC-GRINDEKS 30 mg/ml šķīdums injekcijām

Primary endpoint: Number of patients consented from total approached; Number of patients who completed pain assessment and treatment at all time points (totally for 3 days (72 hours));

Source: https://euclinicaltrials.eu/ctis-public/view/2025-520964-16-00